EU clinical trial 2025-521950-41-00: A Phase 3, Randomized, Double-Blind, Placebo-Controlled Study to Assess the Efficacy and Safety of GB-0895 Adjunctive Therapy in Adults and Adolescents with Severe Uncontrolled Asthma
Protocol code: GB-0895-301
Sponsor: Generate Biomedicines Inc. (Pharmaceutical company). Phase: Therapeutic confirmatory (Phase III). Countries: Latvia (authorised, recruiting), Hungary (authorised, recruitment pending), Bulgaria (ongoing, recruiting), Romania (ongoing, recruiting), Portugal (authorised, recruitment pending), Netherlands (authorised, recruitment pending), Croatia (authorised, recruitment pending), Germany (ongoing, recruiting), Greece (authorised, recruitment pending), Czechia (authorised, recruitment pending).
Therapeutic area(s): Diseases [C] - Respiratory Tract Diseases [C08]
Gender: Female, Male. Age: 0-17 years, 18-64 years, 65+ years. Enrolment: 271.
Start date (EU): 2026-06-05. Decision date: 2026-05-12. Results received: No. Last updated: 2026-07-28.
Decision dates by country: HR: 2026-05-18, CZ: 2026-05-12, PT: 2026-05-15, NL: 2026-05-15, LV: 2026-05-12, GR: 2026-05-13, DE: 2026-05-12, HU: 2026-05-15, BG: 2026-05-18, RO: 2026-05-18

Condition(s): severe uncontrolled asthma
Product: 0.9% sodium chloride, GB-0895

Primary endpoint: Annualized asthma exacerbation rate (AAER) of clinically significant exacerbations over 52 weeks, defined as exacerbations requiring systemic corticosteroids (oral, intravenous [IV], or intramuscular) and/or hospitalization or emergency department visits requiring systemic corticosteroids
Endpoint(s): • AAER over 52 weeks, • Change from baseline in pre-bronchodilator (BD) forced expiratory volume in 1 second (FEV1) at Week 52, • Change from baseline in Asthma Quality of Life Questionnaire (AQLQ(S)12+) score at Week 52, • Change from baseline in Asthma Control Questionnaire (ACQ-6) score at Week 52, • Time to first clinically significant exacerbation from randomization, • Change from baseline in weekly mean daily Asthma Daytime Symptom Diary (ADSD) score at Week 52, • Change from baseline in weekly mean daily Asthma Nighttime Symptom Diary (ANSD) score at Week 52

Source: https://euclinicaltrials.eu/ctis-public/view/2025-521950-41-00